EU clinical trial 2025-523127-21-00: A Study to Evaluate Targeted Therapies for Patients with Rheumatoid Arthritis
Protocol code: M26-033
Sponsor: AbbVie Deutschland GmbH & Co. KG (Pharmaceutical company). Phase: Human Pharmacology (Phase I)- Other. Countries: Belgium (authorised, recruiting), Netherlands (authorised, recruitment pending), Spain (authorised, recruiting), Germany (authorised, recruitment pending), Italy (authorised, recruitment pending).
Therapeutic area(s): Diseases [C] - Immune System Diseases [C20]
Gender: Female, Male. Age: 18-64 years, 65+ years. Enrolment: 19.
Start date (EU): 2026-07-17. Decision date: 2026-07-01. Results received: No. Last updated: 2026-07-02.
Decision dates by country: BE: 2026-07-01, DE: 2026-07-01, IT: 2026-07-01, ES: 2026-07-02, NL: 2026-07-02

Condition(s): Rheumatoid Arthritis

Source: https://euclinicaltrials.eu/ctis-public/view/2025-523127-21-00